EU clinical trial 2025-522165-30-00: An Open-Label, Multicenter Study to Evaluate the Pharmacokinetics and Safety of Xembify versus Gamunex-C in Participants with Chronic Inflammatory Demyelinating Polyradiculoneuropathy (CIDP)
Protocol code: GC2402
Sponsor: Grifols Therapeutics LLC (Pharmaceutical company). Phase: Therapeutic confirmatory (Phase III). Countries: Romania (authorised, recruitment pending), Czechia (authorised, recruiting), Poland (authorised, recruitment pending).
Therapeutic area(s): Diseases [C] - Nervous System Diseases [C10]
Gender: Female, Male. Age: 18-64 years, 65+ years. Enrolment: 20.
Start date (EU): 2026-07-31. Decision date: 2026-07-07. Results received: No. Last updated: 2026-08-07.
Decision dates by country: CZ: 2026-07-07, RO: 2026-07-13, PL: 2026-07-13

Condition(s): Chronic inflammatory demyelinating polyradiculoneuropathy (CIDP)
Product: Xembify 200 mg/ml roztok pro subkutánní injekci, Gamunex® 10%, 100 mg/ml, solution for infusion

Primary endpoint: AUC in the IV Phase: Steady-state AUC of total IgG over a 3-week dosing interval (τ) (i.e., AUC(0−21days) in participants with CIDP, AUC in the SC Phase: Steady-state AUC of total IgG over a weekly SC dosing interval (τ) (i.e., AUC(0−7days)) in participants with CIDP
Endpoint(s): Steady-state mean trough (pre-dose) concentration of total IgG following IV administration of IGIV-C 10% Q3W or SC administration of IGSC 20% QW.

Source: https://euclinicaltrials.eu/ctis-public/view/2025-522165-30-00